EU clinical trial 2024-520140-42-00: Multicenter, randomized, double-blinded, placebo-controlled phase 3 trial to evaluate nonavalent HPV vaccine as a secondary prevention in patients treated for human papilloma virus related high-grade squamous intraepithelial lesions.(BioHPV)
Protocol code: 2024/4031
Sponsor: Institut Gustave Roussy (Hospital/Clinic/Other health care facility). Phase: Therapeutic confirmatory (Phase III). Countries: France (authorised, recruitment pending).
Therapeutic area(s): Diseases [C] - Neoplasms [C04]
Gender: Female, Male. Age: 18-64 years. Enrolment: 984.
Status: Authorised, recruitment pending. Decision date: 2026-01-28. Results received: No. Last updated: 2026-01-28.

Condition(s): Patients with primary HPV high-grade squamous intra-epithelial lesions (HSIL) at any site (vulvar VIN, vaginal VaIN, penile (PeIN), cervical CIN, anal AIN) at the time of treatment.
Product: Gardasil 9 suspension for injection in a pre-filled syringe. Human Papillomavirus 9-valent Vaccine (Recombinant, adsorbed), Gardasil 9 suspension for injection. Human Papillomavirus 9-valent Vaccine (Recombinant, adsorbed), Gardasil 9 suspension for injection in a pre-filled syringe. Human Papillomavirus 9-valent Vaccine (Recombinant, adsorbed), Placebo formulation of Gardasil, Gardasil 9 suspension for injection in a pre-filled syringe. Human Papillomavirus 9-valent Vaccine (Recombinant, adsorbed)

Primary endpoint: The endpoint will be the time to HPV type-specific recurrence of HSIL at the initial site after completed HSIL treatment. Centralised HPV genotyping of the initial HSIL and recurrent lesion will be performed.
Endpoint(s): Time to HPV clearance, Time to HSIL occurrence at different sites, Time to occurrence of invasive HPV-related cancer, Safety based on reported adverse events, Decrease of 50% recurrence rate of HSIL within 2 years of follow-up once the HSIL treatment is completed., Adverse events (AE) according to the National Cancer Institute Common Terminology Criteria for Adverse Events, version 5.0 (NCICTCAE), Viral and Immune signature for HSIL stratification, Assessment of the sexual health of the enrolled patients and current sexual partner(s) at different time points (i.e. baseline, end of 2-years follow-up, end of 5-years follow-up)., Resource use and costs will be assessed from linkage to French National Health Data System (SNDS, Système National des Données de Santé)

Source: https://euclinicaltrials.eu/ctis-public/view/2024-520140-42-00